EU clinical trial 2022-501999-26-00: An Open-Label Extension Study of Olezarsen (ISIS 678354) Administered Subcutaneously to Patients with Severe Hypertriglyceridemia (SHTG)
Protocol code: ISIS 678354-CS15
Sponsor: Ionis Pharmaceuticals Inc. (Pharmaceutical company). Phase: Therapeutic confirmatory (Phase III). Countries: Bulgaria (ongoing, recruitment ended), Hungary (ongoing, recruitment ended), Poland (ongoing, recruitment ended), France (ongoing, recruitment ended), Spain (ongoing, recruitment ended), Czechia (ongoing, recruitment ended), Denmark (ongoing, recruitment ended), Italy (ongoing, recruitment ended), Sweden (ongoing, recruitment ended), Netherlands (ongoing, recruitment ended), Norway (ongoing, recruitment ended), Slovakia (ongoing, recruitment ended), Portugal (ongoing, recruitment ended), Finland (ended), Belgium (ongoing, recruitment ended), Germany (ongoing, recruitment ended), Greece (ongoing, recruitment ended), Lithuania (ongoing, recruitment ended), Romania (ongoing, recruitment ended).
Therapeutic area(s): Diseases [C] - Nutritional and Metabolic Diseases [C18]
Gender: Female, Male. Age: 18-64 years, 65+ years. Enrolment: 502.
Start date (EU): 2023-07-12. Decision date: 2023-05-22. Results received: No. Last updated: 2026-07-21.
Decision dates by country: FI: 2024-08-15, SK: 2023-10-18, IT: 2023-11-16, BG: 2023-05-22, NO: 2023-10-18, DE: 2024-08-06, LT: 2024-08-28, FR: 2023-05-22, HU: 2023-05-22, PL: 2023-05-22, CZ: 2023-10-11, SE: 2023-10-17, GR: 2024-09-09, PT: 2024-07-15, BE: 2024-07-26, NL: 2023-10-12, DK: 2023-09-18, RO: 2024-08-05, ES: 2023-05-22

Condition(s): Severe Hypertriglyceridemia (SHTG)
Product: ISIS 678354, ISIS 678354, ISIS 678354

Primary endpoint: Proportion of Patients With Change in Laboratory Values From Baseline to Week 53, and from Baseline to Week 105, and from Baseline to Week 157. Values include platelet count value <50,000 mm^3, Clinical bleeding events, decrease in eGFR by 30%, decrease in eGFR by ≥ 50%, urine protein/creatinine ratio (UPCR) ≥1000 mg/g, urine/albumin creatinine ratio (UACR) ≥500 mg/g, ALT or AST ≥5 × upper limit of normal (ULN), total bilirubin ≥2.0 mg/dL, and ALT or AST ≥3 × ULN and total bilirubin ≥2 × ULN., Proportion of Participants Who Experience Adverse Events (AEs) [Time Frame: Up to 170 weeks], Proportion of Participants Who Use Concomitant Medications [Time Frame: Up to 170 weeks]

Source: https://euclinicaltrials.eu/ctis-public/view/2022-501999-26-00